EU clinical trial 2024-518908-46-00: Use of [18F]FET PET-MRI to improve detection of pituitary adenomas in Cushing’s disease
Sponsor: Erasmus Universitair Medisch Centrum Rotterdam (Erasmus MC) (Hospital/Clinic/Other health care facility). Phase: Therapeutic confirmatory (Phase III). Countries: Netherlands (authorised, recruitment pending).
Therapeutic area(s): Diseases [C] - Hormonal diseases [C19]
Gender: Female, Male. Age: 18-64 years, 65+ years. Enrolment: 30.
Status: Authorised, recruitment pending. Decision date: 2025-05-15. Results received: No. Last updated: 2025-07-23.

Condition(s): ACTH-dependent hypercortisolism
Product: FET

Primary endpoint: The primary endpoint of this prospective evaluation is the difference in the proportion of patients with ACTH-dependent hypercortisolism in whom CD is correctly distinguished from ectopic CS using [18F]FET PET-MRI versus IPSS. [18F]FET PET-MRI will be compared for non-inferiority to the current standard IPSS.
Endpoint(s): Secondary endpoints include the sensitivity, specificity, positive and negative predictive value of the two techniques for the exact localization of ACTH-secreting PitNETs, based on post-operative neurosurgery and pathology reports as well as biochemical remission as reference standards. The area under the curve (AUC) for both techniques will be calculated from the receiver operating curve (ROC).

Source: https://euclinicaltrials.eu/ctis-public/view/2024-518908-46-00